EU clinical trial 2024-514933-39-00: A Multicenter Phase 1/2, Open-Label Study of DCC-3014 to Assess the Safety, Efficacy, Pharmacokinetics, and Pharmacodynamics in Patients with Advanced Tumors and Tenosynovial Giant Cell Tumor
Protocol code: DCC-3014-01-001
Sponsor: Deciphera Pharmaceuticals Inc. (Pharmaceutical company). Phase: Phase I and Phase II (Integrated)- First administration to humans. Countries: Spain (ongoing, recruitment ended), France (ongoing, recruitment ended), Italy (ongoing, recruitment ended), Poland (ongoing, recruitment ended), Netherlands (ongoing, recruitment ended).
Therapeutic area(s): Diseases [C] - Neoplasms [C04]
Gender: Female, Male. Age: 18-64 years, 65+ years. Enrolment: 54.
Status: Ongoing, recruitment ended. Start date (EU): 2020-05-26. Decision date: 2024-07-11. Results received: No. Last updated: 2025-08-28.
Decision dates by country: ES: 2024-07-16, FR: 2024-07-17, IT: 2024-08-05, NL: 2024-07-11, PL: 2024-07-23

Condition(s): Patients with Advanced Tumors and Tenosynovial Giant Cell Tumor
Product: DCC-3014, DCC-3014, DCC-3014

Primary endpoint: Safety: DLTs, treatment-emergent adverse events (TEAEs), serious adverse events (SAEs), dose reduction or discontinuation of study drug due to toxicity, physical examination findings, ECOG PS, changes from baseline in laboratory parameters, electrocardiograms (ECGs), LVEF, and vital signs., Pharmacokinetics: The following PK endpoints, including but not limited to, will be evaluated for both DCC-3014 parent and its metabolite, DP-7005, if detected: • Time to maximum observed concentration (Tmax) • Maximum observed concentration (Cmax) • Trough observed concentration (Cmin) • Area under the concentration-time curve (AUC) • t1/2, Efficacy (TGCT Expansion Cohort A only): • Objective response rate (ORR=complete response [CR]+partial response [PR]) assessed by independent radiological review using RECIST Version 1.1 at Week 25 (Cycle 7 Day 1) • Duration of Response (DOR; time from PR or CR to disease progression or death)
Endpoint(s): ORR assessed by independent radiological review using TVS and mRECIST (TGCT Expansion Cohort A only), ROM: change from baseline to Week 25 (Cycle 7 Day 1) (TGCT Expansion Cohort A only), Response based on BPI worst pain NRS and narcotic analgesic use by Brief Pain Inventory-30 (BPI-30) at Week 25 (Cycle 7 Day 1) (TGCT Expansion Cohort A only), PRO based upon the PROMIS physical function questionnaire and worst stiffness NRS: Change from starting value to Week 25 (Cycle 7 Day 1) (TGCT Expansion Cohort A only)

Source: https://euclinicaltrials.eu/ctis-public/view/2024-514933-39-00